EU clinical trial 2025-524200-29-00: A prospective, multinational, multicenter, randomized, sequential, double-blind, placebo-controlled, phase 2a clinical study to assess the safety and pharmacokinetics (PK) of OMN6 in hospital-acquired bacterial pneumonia (HABP) or ventilated-associated bacterial pneumonia (VABP) caused by Acinetobacter baumannii complex (ABC).
Protocol code: OMN6-002
Sponsor: Omnix Medical Ltd. (Pharmaceutical company). Phase: Therapeutic exploratory (Phase II). Countries: Italy (authorised, recruitment pending), Hungary (authorised, recruitment pending), Greece (authorised, recruiting).
Therapeutic area(s): Diseases [C] - Respiratory Tract Diseases [C08]
Gender: Female, Male. Age: 18-64 years, 65+ years. Enrolment: 32.
Start date (EU): 2026-07-24. Decision date: 2026-05-06. Results received: No. Last updated: 2026-07-20.
Decision dates by country: GR: 2026-05-07, HU: 2026-05-11, IT: 2026-05-06

Condition(s): Hospital-acquired bacterial pneumonia or ventilated-associated bacterial pneumonia caused by Acinetobacter baumannii complex.
Product: OMN6, SALINE

Primary endpoint: Incidence of TEAE and SAEs by frequency, severity, relatedness, and outcome, clinical laboratory findings, vital signs and ECGs change from baseline and 28-day ACM., OMN6 PK parameters.
Endpoint(s): Proportion of participants with clinical cure, clinical improvement, combined clinical cure plus clinical improvement.

Source: https://euclinicaltrials.eu/ctis-public/view/2025-524200-29-00